EU clinical trial 2024-513173-44-00: HLH-JAK - Treatment of non severe Hemophagocytosis Lymphohistiocytosis with ITACITINIB a Phase II prospective trial
Sponsor: Assistance Publique Hopitaux De Paris (Hospital/Clinic/Other health care facility). Phase: Therapeutic exploratory (Phase II). Countries: France (ended).
Therapeutic area(s): Diseases [C] - Hemic and Lymphatic Diseases [C15]
Gender: Female, Male. Age: 18-64 years, 65+ years. Enrolment: 70.
Status: Ended. Start date (EU): 2022-05-03. End date (EU): 2025-07-25. Decision date: 2024-07-29. Results received: No. Last updated: 2025-03-17.

Condition(s): Adults patients having non severe HLH
Product: Itacitinib

Primary endpoint: Overall response rate (RR) achievement of either a Complete (CR) or a Partial response (PR) at day 15 of ITACITINIB treatment on clinical and biological symptoms of primitive/refractory/relapses in non-severe adults HLHs

Source: https://euclinicaltrials.eu/ctis-public/view/2024-513173-44-00